EU clinical trial 2023-505604-32-00: Randomized, Open-label, Multicenter, Phase 3 Trial of Repotrectinib Versus Crizotinib in Participants with Locally Advanced or Metastatic Tyrosine Kinase Inhibitor (TKI)-naïve ROS1 positive Non-Small Cell Lung Cancer (NSCLC) (TRIDENT-3)
Protocol code: CA127-1030
Sponsor: Bristol-Myers Squibb Services Unlimited Company (Pharmaceutical company). Phase: Therapeutic confirmatory (Phase III). Countries: Greece (ended), France (ongoing, recruitment ended), Austria (ended), Romania (ongoing, recruitment ended), Spain (ongoing, recruitment ended), Poland (ended), Hungary (ended), Germany (ongoing, recruitment ended), Italy (ongoing, recruitment ended), Netherlands (ended).
Therapeutic area(s): Diseases [C] - Neoplasms [C04]
Gender: Female, Male. Age: 18-64 years, 65+ years. Enrolment: 83.
Start date (EU): 2024-01-24. Decision date: 2024-01-10. Results received: No. Last updated: 2026-05-18.
Decision dates by country: HU: 2024-01-15, GR: 2024-01-15, NL: 2024-08-02, AT: 2024-01-15, RO: 2024-01-15, ES: 2024-01-10, IT: 2024-01-12, PL: 2024-01-12, DE: 2024-01-12, FR: 2024-01-10

Condition(s): Non small cell lung cancer (NSCLC)
Product: XALKORI 250 mg hard capsules, XALKORI 200 mg hard capsules, Repotrectinib (TPX-0005), Repotrectinib (TPX-0005)

Primary endpoint: PFS per BICR, according to RECIST v1.1
Endpoint(s): Overall Survival, Objective Response Rate (ORR), Duration of Response (DOR), Time to Response (TTR) per BICR and per investigator according to RECIST v1.1, PFS per investigator according to RECIST v1.1, Time to intracranial progression per BICR according to RECIST v1.1, Incidence of Adverse Events (AEs), Serious Adverse Events (SAEs), AEs leading to study intervention discontinuation, Drug-related AEs and deaths, Proportion of participants without meaningful symptom deterioration as measured by the NSCLC-SAQ total score

Source: https://euclinicaltrials.eu/ctis-public/view/2023-505604-32-00